EU clinical trial 2023-508859-39-00: A two-part randomized, double-blind, placebo-controlled multicenter dose ranging and confirmatory study to assess the safety and efficacy of VAY736 in autoimmune hepatitis patients with incomplete response to or intolerance of standard therapy (AMBER)
Protocol code: CVAY736B2201
Sponsor: Novartis Pharma AG (Pharmaceutical company). Phase: Phase II and Phase III (Integrated). Countries: Czechia (ended), Germany (ended).
Therapeutic area(s): Diseases [C] - Immune System Diseases [C20]
Gender: Female, Male. Age: 18-64 years, 65+ years. Enrolment: 7.
Status: Ended. Start date (EU): 2018-02-15. End date (EU): 2025-12-17. End date: 2025-12-18. Decision date: 2024-01-31. Results received: No. Last updated: 2026-01-23.
Decision dates by country: DE: 2024-01-31, CZ: 2024-02-05

Condition(s): Autoimmune hepatitis
Product: Placebo 0 mg/1 mL Solution for infusion/injection, VAY736

Primary endpoint: Proportion of patients with normalization of ALT at Week 24
Endpoint(s): Proportion of patients achieving ALT normalization at Week 24

Source: https://euclinicaltrials.eu/ctis-public/view/2023-508859-39-00